EU clinical trial 2024-516100-42-00: PICASSO. Prospective randomIzed clinical trial assessing the tolerance and clinical benefit of feCAl tranSplantation in patientS with melanOma treated with CTLA-4 and PD-1 inhibitors
Protocol code: APHP200133
Sponsor: Assistance Publique Hopitaux De Paris (Hospital/Clinic/Other health care facility). Phase: Therapeutic exploratory (Phase II). Countries: France (ended).
Therapeutic area(s): Diseases [C] - Neoplasms [C04]
Gender: Female, Male. Age: 18-64 years, 65+ years. Enrolment: 70.
Status: Ended. Start date (EU): 2022-03-18. End date (EU): 2025-04-22. Decision date: 2024-09-27. Results received: No. Last updated: 2025-07-10.

Condition(s): Melanoma
Product: MaaT013, Placebo de MaaT013 - Major ingredients: Calcium carbonate; Xanthan gum; Alimentary colorant; E150d: caramel color; HCl;Purified water

Primary endpoint: Safety will be measured by the occurrence of treatment-related adverse events of Grade 3, grade 4 and grade 4 , as graded by the CTCAE v 5.0 during the 27 weeks of the trial
Endpoint(s): Efficacy will be assessed by the best overall response rate, between baseline and week 27, without confirmation of partial or complete response, rated by Response Evaluation Criteria in Solid Tumors (RECIST v1.1; 19) in the experimental and control arms, Changes in the tumor micro environment (CD3, CD8, FoxP3, CD56, granzyme B, CD68, CD163, CD20, PD1) pre and post MaaT013 or placebo, Changes in plasma levels of proteins or metabolites that play a role in immune activity against cancer and/or are associated with gut microbiome composition, pre and post ipilimumab + nivolumab with MaaT013 or placebo, Changes in peripheral blood immune cell subpopulations pre and post ipilimumab + nivolumab with MaaT013 or placebo, Changes in gut microbiome and metabolites pre and post MaaT013 or placebo and in patients who met the inclusion criteria, received Ipilimumab+Nivolumab, agreed to have stool microbiome analyses at baseline and week 9, but did not receive MaaT013 or placebo, Best response rate, either complete or partial, rated by RECIST and iRECIST in patients with disease progression who received placebo and subsequently, MaaT013, in an open-label basis, Progression-free survival rated by RECIST and iRECIST at week 15, 27, 51, Overall survival rated by RECIST and iRECIST at week 15, 27, 51, Best overall response rate, with or without confirmation of complete or partial response, rated by iRECIST and PET scan at weeks 15, 27 and 51 using EORTC criteria, Disease control rate (complete or partial response or stable disease) rated by RECIST and iRECIST, Pseudo progression rate evaluated by iRECIST, The favorable gut microbiome is the one associated with the favorable response to ipilimumab and nivolumab. The description of favorable microbiome will be based upon baseline analyses performed in patients of the placebo arm, but also in patients who met the inclusion criteria, received Ipilimumab+Nivolumab, who consented to have a baseline stool microbiota analysis, but were not included in the randomized trial., Best overall response rate, with confirmation of response, between baseline and week 27 rated by RECIST, Time point assessment of response (either partial or complete), stable disease and progression at week 15, 27 and 51

Source: https://euclinicaltrials.eu/ctis-public/view/2024-516100-42-00